EU clinical trial 2025-522468-34-00: Phase I clinical trial evaluating the safety, tolerability, and absorption of a topical product containing latanoprost acid in healthy participants.
Protocol code: LA/BRP/02/25
Sponsor: Bioresearch Pharma S.A. (Pharmaceutical company). Phase: Human Pharmacology (Phase I)- Other. Countries: Poland (ongoing, recruiting).
Therapeutic area(s): Diseases [C] - Skin and Connective Tissue Diseases [C17]
Gender: Female, Male. Age: 18-64 years. Enrolment: 24.
Status: Ongoing, recruiting. Start date (EU): 2026-07-21. Decision date: 2026-04-29. Results received: No. Last updated: 2026-04-29.

Condition(s): Androgenetic alopecia

Source: https://euclinicaltrials.eu/ctis-public/view/2025-522468-34-00